EU clinical trial 2024-512132-29-00: SAKK 08/23: Addition of Darolutamide to first line treatment of mCRPC: a randomized open label phase II trial
Protocol code: SAKK 08/23
Sponsor: Swiss Group for Clinical Cancer Research (Patient organisation/association). Phase: Therapeutic exploratory (Phase II). Countries: Spain (ongoing, recruiting).
Therapeutic area(s): Diseases [C] - Male Urogenital Diseases [C12]
Gender: Male. Age: 18-64 years, 65+ years. Enrolment: 100.
Status: Ongoing, recruiting. Start date (EU): 2025-08-06. Decision date: 2025-05-22. Results received: No. Last updated: 2026-06-12.

Condition(s): Metastatic castration-resistant prostate cancer
Product: BAY 1841788, Lutathera 370 MBq/mL solution for infusion, Cabazitaxel Accord 20 mg/ml concentrate for solution for infusion, Lynparza 150 mg film-coated tablets, Xofigo 1100 kBq/mL solution for injection, Docetaxel Aurovitas 20 mg/ml concentrado para solución para perfusión

Primary endpoint: Radiographic progression-free survival.
Endpoint(s): Overall survival., Time to symptomatic/clinical progression., Time to PSA progression (defined according to PCWG3)., Event-free survival (EFS) – event being defined as one of the following: - death from any cause - presence of radiographic progression and symptomatic/clinical progression; - presence of radiographic progression and PSA progression; - presence of symptomatic/clinical progression and PSA progression, Objective response rate according to RECIST., PSA response (30%, 50%, 90% and best)., Duration of PSA response (50%)., AEs.

Source: https://euclinicaltrials.eu/ctis-public/view/2024-512132-29-00